EU clinical trial 2024-512165-13-00: ARION : Association of Radiochemotherapy and Immunotherapy for the treatment of unresectable Oesophageal caNcer: a comparative randomized phase II trial
Protocol code: UC-0110/1719
Sponsor: Unicancer (Hospital/Clinic/Other health care facility). Phase: Therapeutic exploratory (Phase II). Countries: France (ongoing, recruitment ended).
Therapeutic area(s): Diseases [C] - Neoplasms [C04]
Gender: Female, Male. Age: 18-64 years, 65+ years. Enrolment: 120.
Status: Ongoing, recruitment ended. Start date (EU): 2019-05-13. Decision date: 2024-05-28. Results received: No. Last updated: 2024-05-28.

Condition(s): Localised unresectable adenocarcinoma or squamous cell carcinoma of the oesophagus without any prior chemotherapy, surgery, or radiotherapy
Product: IMFINZI 50 mg/mL concentrate for solution for infusion., FLUOROURACIL, FOLINIC ACID, OXALIPLATIN

Primary endpoint: The primary endpoint is defined by a blinded independent centralized revue of progression free survival. cPFS is defined as the time from randomization until progression or death; patients alive and without documented progression at last follow-up news have PFS censored at this date or at initiation of new anticancer treatment (if applicable). Progression will be assessed by a blinded independent centralized revue of TDM per RECIST criteria 1.1
Endpoint(s): Progression-Free Survival (PFS) is defined as the time from randomization until progression or deaths; patients alive and without progression at last follow-up news are censored at this date., Overall survival (OS): OS is defined by the delay between randomization and the occurrence of death due to any cause. Patients still alive at the time of analysis (including lost of follow-up) will be censored at the last known alive date., Safety: safety will be assessed by the toxicity grading of the National Cancer Institute (NCI-CTCAE v 5.0, appendix 3). Adverse event (AE) occurrence will be detected by changes occurring in the course of treatment observed during clinical examination, in particular on vital signs (artery pressure, pulse, body temperature), in electrocardiogram (ECG) and biological tests (biochemistry, hematology). Use of concomitant treatments will be also taken into account., Quality of life: Quality of life (QL) assessed by the European Organization for Research and Treatment of Cancer (EORTC) core QL questionnaire, the EORTC QLQ-C30 and Oes18 (Oesophageal Cancer Module).

Source: https://euclinicaltrials.eu/ctis-public/view/2024-512165-13-00